EU clinical trial 2023-505051-43-00: Comparison of STep-up and step-down therapeutic strategies in childhood ARthritiS
Protocol code: The STARS trial
Sponsor: Giannina Gaslini Institute For Scientific Hospitalization And Care (Hospital/Clinic/Other health care facility). Phase: Therapeutic confirmatory (Phase III). Countries: Italy (ongoing, recruiting).
Therapeutic area(s): Diseases [C] - Immune System Diseases [C20]; Diseases [C] - Musculoskeletal Diseases [C05]
Gender: Female, Male. Age: 0-17 years. Enrolment: 260.
Status: Ongoing, recruiting. Start date (EU): 2024-09-04. Decision date: 2024-09-04. Results received: No. Last updated: 2025-09-30.

Condition(s): juvenile idiopathic arthritis
Product: Reumaflex 50 mg/ml soluzione iniettabile, siringa preriempita, Enbrel 25 mg solution for injection in pre-filled syringe, Reumaflex 50 mg/ml soluzione iniettabile, siringa preriempita, Reumaflex 50 mg/ml soluzione iniettabile, siringa preriempita, Enbrel 10 mg powder and solvent for solution for injection for paediatric use, Reumaflex 50 mg/ml soluzione iniettabile, siringa preriempita, Reumaflex 50 mg/ml soluzione iniettabile, siringa preriempita, Reumaflex 50 mg/ml soluzione iniettabile, siringa preriempita, Enbrel 50 mg solution for injection in pre-filled syringe

Primary endpoint: Clinical remission on or off medication at 12 months.
Endpoint(s): The rate of patients who achieve the JADAS/JIA ACR state of ID at any single point in time throughout the study period will be compared between the 2 arms.

Source: https://euclinicaltrials.eu/ctis-public/view/2023-505051-43-00